EU clinical trial 2025-521707-48-00: AMG 410 Alone and in Combination with other agents in Participants with KRAS Altered Advanced or Metastatic Solid Tumors
Protocol code: 20240031
Sponsor: Amgen Inc. (Pharmaceutical company). Phase: Human Pharmacology (Phase I)- First administration to humans. Countries: France (ongoing, recruiting), Netherlands (ongoing, recruiting), Germany (ongoing, recruiting), Denmark (ongoing, recruiting), Spain (ongoing, recruiting), Italy (ongoing, recruiting), Belgium (ongoing, recruiting).
Therapeutic area(s): Diseases [C] - Neoplasms [C04]
Gender: Female, Male. Age: 18-64 years, 65+ years. Enrolment: 135.
Status: Ongoing, recruiting. Start date (EU): 2025-11-26. Decision date: 2025-10-28. Results received: No. Last updated: 2026-05-04.
Decision dates by country: DK: 2025-10-28, FR: 2025-10-29, DE: 2025-10-29, IT: 2025-10-30, ES: 2025-10-31, NL: 2025-10-29, BE: 2025-10-28

Condition(s): KRAS Altered Advanced or Metastatic Solid Tumors

Source: https://euclinicaltrials.eu/ctis-public/view/2025-521707-48-00